EU clinical trial 2023-507404-31-03: Mechanisms of Action of Paradoxical Responses to Zolpidem: A Multimodal Study
Sponsor: Universite De Liege (Educational Institution). Phase: Therapeutic exploratory (Phase II). Countries: Belgium (temporarily halted).
Therapeutic area(s): Analytical, Diagnostic and Therapeutic Techniques and Equipment [E] - Therapeutics [E02]; Phenomena and Processes [G] - Physiological processes [G07]; Diseases [C] - Nervous System Diseases [C10]
Gender: Female, Male. Age: 18-64 years, 65+ years. Enrolment: 180.
Status: Temporarily halted. Start date (EU): 2025-02-11. Decision date: 2025-01-23. Results received: No. Last updated: 2026-07-14.

Condition(s): Patients with acquired partial/total vision impairments, Neurotypical volunteers (representing the general population), Patients with Disorders of Consciousness (DoC)
Product: Zolpidem Viatris 10 mg comprimés pelliculés, MANNITOL

Primary endpoint: DoC patients: Consciousness level (Coma Recovery Scale-Revised – CRS-R); Neural complexity (high density electroencephalography – hdEEG); Phenomenological experiences (Free recall/interview, if the patient recovers functional communication after IMP/placebo administration), Neurotypical volunteers: Alertness/sleepiness level (Karolinska Sleepiness Scale – KSS); Cognitive performance (Standardised neuropsychological tests); Neural complexity (high density electroencephalography – hdEEG); Phenomenological experiences (Free recall/interview), Patients with vision impairments: Alertness/sleepiness level (Karolinska Sleepiness Scale – KSS); Cognitive performance (Standardised neuropsychological tests); Neural complexity (high density electroencephalography – hdEEG); Phenomenological experiences (Free recall/interview); Visual functions (ophthalmological testing by a neuro-ophthalmologist)

Source: https://euclinicaltrials.eu/ctis-public/view/2023-507404-31-03